EU clinical trial 2025-521918-26-00: A Phase 2b Randomized, Open-Label Active Controlled Study Evaluating the Safety and Efficacy of oral VH4524184 Coadministered with Emtricitabine and Tenofovir Alafenamide in Treatment Naïve Viremic Persons with HIV-1.( INNOVATE Study)
Protocol code: 222638
Sponsor: Viiv Healthcare UK Limited (Pharmaceutical company). Phase: Therapeutic exploratory (Phase II). Countries: Spain (ongoing, recruitment ended), Belgium (ongoing, recruitment ended), France (ongoing, recruitment ended), Germany (ongoing, recruitment ended), Italy (ongoing, recruitment ended), Portugal (ongoing, recruiting), Poland (ongoing, recruitment ended).
Therapeutic area(s): Diseases [C] - Virus Diseases [C02]
Gender: Female, Male. Age: 18-64 years, 65+ years. Enrolment: 175.
Start date (EU): 2026-02-11. Decision date: 2026-01-23. Results received: No. Last updated: 2026-05-04.
Decision dates by country: ES: 2026-01-23, BE: 2026-04-15, FR: 2026-04-28, DE: 2026-04-20, IT: 2026-04-17, PT: 2026-03-25, PL: 2026-05-04

Condition(s): HIV Infections
Product: Dovato 50 mg/300 mg film-coated tablets, Descovy 200 mg/25 mg film-coated tablets

Primary endpoint: Plasma HIV-1 RNA <50 copies/mL (FDA snapshot) at Month 12
Endpoint(s): • Plasma HIV-1 RNA <50 copies/mL (observed) until Month 24. • Plasma HIV-1 RNA <50 copies/mL (FDA snapshot) until Month 24., Change from baseline in CD4+ T-cell count until Month 24., To assess the safety and tolerability of oral VH4524184 containing regimens compared to the DTG/3TC FDC oral control arm, To assess the PK of VH4524184 during the Treatment Period

Source: https://euclinicaltrials.eu/ctis-public/view/2025-521918-26-00